EU clinical trial 2024-518363-36-00: A PHASE I/II STUDY TO EVALUATE THE SAFETY AND EFFICACY OF MEBENDAZOLE IN COMBINATION WITH LOW-DOSE ARA-C IN ELDERLY PATIENTS WITH RELAPSED/REFRACTORY ACUTE MYELOID LEUKEMIA (MAIL)
Protocol code: MAIL
Sponsor: University Medical Center Hamburg-Eppendorf (Hospital/Clinic/Other health care facility). Phase: Therapeutic exploratory (Phase II). Countries: Germany (ended).
Therapeutic area(s): Diseases [C] - Neoplasms [C04]
Gender: Female, Male. Age: 65+ years. Enrolment: 50.
Status: Ended. End date (EU): 2025-08-21. Decision date: 2024-10-30. Results received: No. Last updated: 2025-02-10.

Condition(s): relapsed/refractory acute myeloid leukemia
Product: VERMOX forte, 500 mg Tabletten, CYTARABINE, VERMOX, 100 mg Tabletten

Primary endpoint: Phase I: Determination of MTD by recording frequency and severity of adverse events graded by CTCAE v5.0., Phase I: Determination of a biologically relevant Phase II regimen, Phase II: Combined rate of complete remission (CR) and morphologic complete remission with incomplete blood count recovery (CRi) within three months
Endpoint(s): Phase I: PD parameters such as a modified PIA assay, Phase I: PK analysis, Phase II: Determination of GLI1/2 levels in circulating AML cells before and under treatment, Phase II: Determination of Event free and Overall survival, Phase II: Determination of subclonal response by NGS, Phase II: Performing minimal residual disease assessment (MRD) in responding patients by NGS

Source: https://euclinicaltrials.eu/ctis-public/view/2024-518363-36-00